EU clinical trial 2025-520993-20-00: A Phase 2 Open-label Multicenter Study to Evaluate the Pharmacokinetics, Pharmacodynamics, Safety and Tolerability of Inebilizumab in Children From 2 Years to less than 18 Years of age With Generalized Myasthenia Gravis (gMG)
Protocol code: 20240236
Sponsor: Amgen Inc. (Pharmaceutical company). Phase: Therapeutic exploratory (Phase II). Countries: Spain (ongoing, recruiting), Italy (authorised, recruiting), Poland (ongoing, recruiting), France (authorised, recruiting).
Therapeutic area(s): Diseases [C] - Nervous System Diseases [C10]
Gender: Female, Male. Age: 0-17 years. Enrolment: 4.
Start date (EU): 2026-05-19. Decision date: 2026-02-09. Results received: No. Last updated: 2026-07-16.
Decision dates by country: IT: 2026-02-10, FR: 2026-02-10, ES: 2026-02-11, PL: 2026-02-09

Condition(s): Generalized Myasthenia Gravis
Product: Uplizna 100 mg concentrate for solution for infusion

Primary endpoint: "Pharmacokinetic parameters, including maximum observed concentration (Cmax), area under the concentration-time curve (AUC), half-life (t1/2), clearance (CL) and volume of distribution at steady state (Vss)", Change from baseline in cluster of differentiation 20 (CD20)+ B-cell counts, "Incidence of treatment-emergent adverse events, treatment-emergent serious adverse events, adverse events of interest", Changes in laboratory parameters, Changes in vital signs
Endpoint(s): Change in Quantitative Myasthenia Gravis (QMG) score, Change in Myasthenia Gravis Activities of Daily Living (MG-ADL) score, Presence of anti-drug antibodies (ADAs), "Change in Euro Quality of Life-5 Dimension Youth score", "Change in Neurological Quality of Life Pediatric Fatigue score"

Source: https://euclinicaltrials.eu/ctis-public/view/2025-520993-20-00